EU clinical trial 2023-504825-38-00: A Phase 2, Randomized, Double‑blind, Placebo‑controlled, Dose‑finding Study to Evaluate the Efficacy and Safety of ALXN2050 in Adult Participants with Proliferative Lupus Nephritis (LN) or Immunoglobulin A Nephropathy (IgAN)
Protocol code: ALXN2050-NEPH-201
Sponsor: Alexion Pharmaceuticals Inc. (Pharmaceutical company). Phase: Therapeutic exploratory (Phase II). Countries: Germany (ended), Spain (ended), Italy (ended).
Therapeutic area(s): Diseases [C] - Immune System Diseases [C20]
Gender: Female, Male. Age: 18-64 years, 65+ years. Enrolment: 35.
Status: Ended. Start date (EU): 2022-04-15. End date (EU): 2024-11-14. End date: 2024-12-09. Decision date: 2024-05-17. Results received: Yes. Last updated: 2025-02-20.
Decision dates by country: DE: 2024-05-17, IT: 2024-05-21, ES: 2024-05-20

Condition(s): Lupus Nephritis (LN) Immunoglobulin A Nephropathy (IgAN)
Product: ALXN 2050, ALXN2050 Placebo Tablets

Primary endpoint: Percentage change in proteinuria
Endpoint(s): 1) Percentage change in proteinuria 2) Achieving > 30% and > 50% reduction in proteinuria 3)Change from baseline in eGFR 4)PK/PD - Observed plasma concentrations of ALXN2050 5)PK/PD - Absolute values and change from baseline in plasma Bb concentration and serum AP activity 6) Safety - Incidence of TEAEs and TESAEs 7) Safety - Changes from baseline in laboratory assessments LN Cohort Only: 8) Meeting the criteria for complete renal response (CRR) 9) Meeting the criteria for partial renal response

Source: https://euclinicaltrials.eu/ctis-public/view/2023-504825-38-00